EU clinical trial 2024-510944-30-00: A RANDOMIZED, DOUBLE-MASKED, MULTI-CENTER, 3-ARM PHASE 2/3 STUDY TO EVALUATE THE EFFICACY AND SAFETY OF INTRAVITREAL EYE103 COMPARED WITH INTRAVITREAL RANIBIZUMAB (0.5MG) IN PARTICIPANTS WITH DIABETIC MACULAR EDEMA
Protocol code: EYE-RES-102
Sponsor: Eyebiotech Limited (Laboratory/Research/Testing facility). Phase: Phase II and Phase III (Integrated). Countries: Italy (ongoing, recruitment ended), Germany (ongoing, recruitment ended), Latvia (ongoing, recruitment ended), Hungary (ongoing, recruitment ended), France (ongoing, recruitment ended), Czechia (ongoing, recruitment ended), Austria (ongoing, recruitment ended), Poland (ongoing, recruitment ended), Slovakia (ongoing, recruitment ended), Croatia (ongoing, recruitment ended), Portugal (ongoing, recruitment ended), Spain (ongoing, recruitment ended).
Therapeutic area(s): Diseases [C] - Eye Diseases [C11]
Gender: Female, Male. Age: 18-64 years, 65+ years. Enrolment: 585.
Status: Ongoing, recruitment ended. Start date (EU): 2024-11-22. Decision date: 2024-11-11. Results received: No. Last updated: 2026-06-12.
Decision dates by country: FR: 2024-11-12, SK: 2024-11-11, LV: 2024-11-15, IT: 2024-11-11, ES: 2024-11-15, DE: 2024-11-11, AT: 2024-11-18, PT: 2024-11-12, HR: 2024-11-19, HU: 2024-11-15, CZ: 2024-11-12, PL: 2024-12-19

Condition(s): Diabetic Macular Edema
Product: EYE103, Lucentis 10 mg/ml solution for injection, EYE103, Fluorescein Alcon® 10 % Injektionslösung

Primary endpoint: The primary endpoint is defined as the mean change in ETDRS BCVA from Baseline (Day 1) to Year 1 (average of Weeks 48 and 52).

Source: https://euclinicaltrials.eu/ctis-public/view/2024-510944-30-00